EU clinical trial 2023-508525-27-00: A multiarm, randomized, open label Clinical study comparing AntiatheroSClerotic efficacy of selected Antidiabetic agents in patients with coronary artery disease and preDiabetES. A randomised clinical trial (CASCADES)
Protocol code: CSDS.IV/VIII/2023
Sponsor: Narodowy Instytut Kardiologii Stefana Kardynala Wyszynskiego Panstwowy Instytut Badawczy (Hospital/Clinic/Other health care facility). Phase: Therapeutic use (Phase IV). Countries: Poland (ongoing, recruiting).
Therapeutic area(s): Diseases [C] - Cardiovascular Diseases [C14]
Gender: Female, Male. Age: 18-64 years, 65+ years. Enrolment: 300.
Status: Ongoing, recruiting. Start date (EU): 2025-07-10. Decision date: 2024-03-08. Results received: No. Last updated: 2025-08-27.

Condition(s): Coronary Heart Disease, Prediabetes, Coronary Atherosclerosis, Coronary Artery Disease
Product: Forxiga 10 mg film-coated tablets, Rybelsus 3 mg tablets, Formetic 500 mg, tabletki powlekane, Rybelsus 14 mg tablets, Rybelsus 7 mg tablets

Primary endpoint: The impact of GLP-1 analogue treatment on the progression of coronary artery disease (expressed as a change in the % change in the volume of non-calcified atherosclerotic plaque in CT assessed by coronary CT) in relation to routine treatment (intention-to-treat);, The impact of flozin treatment on the progression of coronary artery disease (expressed as a change in the % change in the volume of non-calcified atherosclerotic plaque at heart rate assessed in coronary CT) in relation to routine treatment (intention-to-treat);
Endpoint(s): The effect of each of the tested drugs vs. the control group on the progression of coronary artery disease (expressed as a change in the % change in the volume of uncalcified atherosclerotic plaque in t.w. assessed in coronary CT) (as treated);, Comparison of the effect of semaglutide vs. flozin on the progression of coronary artery disease (expressed as a change in the % change in the volume of uncalcified atherosclerotic plaque at heart rate assessed by coronary CT scan)(intention to treat/as treated);, The effect of each of the tested drugs vs. the control group/comparison of the effect of semaglutide vs. flozin on the progression of coronary artery disease (expressed as a % change in the volume of the entire atherosclerotic plaque in t.w. assessed in coronary CT); (intention to treat/as treated), The effect of each of the tested drugs vs. the control group/comparison of the effect of semaglutide vs. flozin on the progression of coronary artery disease (expressed as a % change in the volume of individual components of the atherosclerotic plaque in CT assessed in coronary CT); (intention to treat/as treated);, Assessment of the effect of each of the studied drugs vs. the control group/comparison of the effect of semaglutide vs. flozin on the progression of coronary artery disease (expressed as the conversion of non-calcified plaque into calcified plaque in CT assessed in coronary CT); (intention to treat/as treated);, Assessment of the impact of individual tested drugs vs. the control group/comparison of the effect of semaglutide vs. flozin on the risk of SN expressed as the dynamics of high-risk features 1. Change in the number of high-risk atherosclerotic lesions defined as the presence of at least 2 high-risk features among: spotty calcifications, low attenuation plaque, i.e. plaque density < 30 HU, positive remodeling, napkin ring sign assessed in koro-CT 2. Change in Pericoronary FAI assessed in koro-CT, Evaluation of weight change, including body composition, in patients treated with semaglutide vs. patients treated with flozin - weight - body mass index (BMI). - fat mass - skeletal muscle mass - Fat-To-Muscle Ratio (FMR). - Body Cell Mass (BCM) - Visceral Fat Area (VFA, Evaluation of waist-to-hip index (WHI) change in patients treated with semaglutide vs. patients treated with phlorizin, Evaluation of change in inflammatory parameters in patients treated with semaglutide vs. patients treated with phlorizin. Concentration of hsCRP, Evaluation of change in lipid levels in patients treated with semaglutide vs. patients treated with flozin. - total cholesterol - low-density lipoproteins (LDL) - high-density lipoproteins (HDL) - non-HDL cholesterol - triglycerides - lipoprotein A, Evaluation of change in the percentage of glycated hemoglobin (HBA1c) in patients treated with semaglutide vs. patients treated with flozin, Evaluation of change in the percentage of patients with normal blood pressure in patients treated with semaglutide vs. patients treated with flozin. Change in percentage of patients with normal blood pressure defined as systolic pressure <140 mmHg and diastolic pressure <90 mmHg, Change in the percentage of patients who smoke tobacco, Evaluation of compliance with physical activity recommendations in patients treated with semaglutide vs. patients treated with flozin. - Percentage of patients classified in the "high" physical activity category; - Percentage of patients classified in the "sufficient" physical activity category; - Percentage of patients classified in the "insufficient" physical activity category, Evaluation of dietary compliance in patients treated with semaglutide vs. patients treated with flozin. Change in the DASH Index between baseline and end of study, Diagnosis of diabetes based on the criteria of the Polish Diabetes Association, Evaluation of the onset of heart failure requiring hospitalization. Hospitalization for heart failure., Number of unplanned hospitalizations, Number of major cardiovascular events and strokes (MACCE: death/myocardial infarction/revascularization/stroke) separately and combined., Homeostatic Model Change Assessment – Insulin Resistance (HOMA-IR)., Assessment of changes in the concentration of selected oxidative stress markers.Change in concentration of selected oxidative stress markers: catalase, superoxide dismutase (SOD), Oxygen Radical Absorbance Capacity (ORAC), total antioxidant capacity (TAC)

Source: https://euclinicaltrials.eu/ctis-public/view/2023-508525-27-00